EU clinical trial 2024-514466-38-00: A Phase 3, Multicenter, Open-label, Long-term, Extension Study to Evaluate Safety and Tolerability of Oral Dersimelagon (MT-7117) in Subjects with Erythropoietic Protoporphyria (EPP) or X-Linked Protoporphyria (XLP)
Protocol code: MT-7117-A-301
Sponsor: Tanabe Pharma America Inc. (Pharmaceutical company). Phase: Therapeutic confirmatory (Phase III). Countries: Norway (ongoing, recruitment ended), Sweden (ongoing, recruitment ended), Italy (ongoing, recruitment ended), Spain (ongoing, recruitment ended), Germany (ongoing, recruitment ended), Bulgaria (ongoing, recruitment ended), Czechia (ongoing, recruitment ended), France (ongoing, recruitment ended), Netherlands (ongoing, recruitment ended), Poland (ongoing, recruitment ended).
Therapeutic area(s): Diseases [C] - Pathological Conditions, Signs and Symptoms [C23]
Gender: Female, Male. Age: 0-17 years, 18-64 years, 65+ years. Enrolment: 90.
Status: Ongoing, recruitment ended. Start date (EU): 2022-04-19. Decision date: 2024-07-18. Results received: No. Last updated: 2026-06-25.
Decision dates by country: SE: 2024-07-22, ES: 2024-07-18, NO: 2024-07-25, BG: 2025-06-11, NL: 2025-06-19, CZ: 2025-07-11, DE: 2024-07-26, PL: 2025-07-07, FR: 2025-06-13, IT: 2024-07-24

Condition(s): Erythropoietic Protoporphyria (EPP) or X-Linked Protoporphyria (XLP)
Product: MT-7117 Formulation Code C

Primary endpoint: Treatment-emergent adverse events (TEAEs) (including serious adverse events [SAEs] and adverse events of special interest [AESIs])., Physical examination., Vital signs (blood pressure, respiratory rate, pulse rate, and body temperature)., Clinical laboratory examinations (hematology, coagulation, biochemistry, and urinalysis), including liver function markers (aspartate aminotransferase [AST], alanine aminotransferase [ALT], gamma glutamyl transpeptidase [GGT], alkaline phosphatase [ALP], direct and total bilirubin)., 12-lead electrocardiogram (ECG) parameters., Nevi appearance (assessed by a dermatologist or other qualified site staff). Any nevi undergoing change of clinical concern during active treatment will be biopsied for follow-up and evaluated by the central pathology lab.

Source: https://euclinicaltrials.eu/ctis-public/view/2024-514466-38-00